EU clinical trial 2024-514761-19-00: A Randomized, Double-blind, Placebo-controlled, Multinational, Phase 3 Study of the Efficacy and Safety of Inhaled Treprostinil in Subjects with Idiopathic Pulmonary Fibrosis (TETON-2)
Protocol code: RIN-PF-303
Sponsor: United Therapeutics Corp. (Pharmaceutical company). Phase: Therapeutic confirmatory (Phase III). Countries: Belgium (ended), Germany (ended), Denmark (ended), Italy (ended), France (ended), Netherlands (ended), Spain (ended).
Therapeutic area(s): Diseases [C] - Respiratory Tract Diseases [C08]
Gender: Female, Male. Age: 18-64 years, 65+ years. Enrolment: 382.
Status: Ended. Start date (EU): 2023-01-25. End date (EU): 2025-06-25. End date: 2025-06-30. Decision date: 2024-08-26. Results received: Yes. Last updated: 2025-01-31.
Decision dates by country: IT: 2024-09-23, DK: 2024-08-29, DE: 2024-08-28, ES: 2024-08-26, NL: 2024-08-26, FR: 2024-08-26, BE: 2024-08-26

Condition(s): Idiopathic Pulmonary Fibrosis
Product: The Placebo Nebuliser Solution is a solution dosage form for nebulisation identical to Treprostinil Nebuliser Solution drug product except for the absence of the treprostinil drug substance., Treprostinil

Primary endpoint: The primary endpoint of the study is the change in absolute FVC in subjects with IPF from baseline to Week 52.
Endpoint(s): • Time to clinical worsening (including time to death, respiratory hospitalization, or ≥10% relative decline in % predicted FVC) • Time to first acute exacerbation of IPF • Overall survival at Week 52 • Change from baseline in % predicted FVC at Week 52 • Change from baseline in King's Brief Interstitial Lung Disease Questionnaire score at Week 52 •Change from baseline in diffusion capacity of lungs for carbon monoxide at Week 52

Source: https://euclinicaltrials.eu/ctis-public/view/2024-514761-19-00